EU clinical trial 2024-517316-29-00: A multicenter randomized open label phase II study evaluating the efficacy and the tolerance of adding cemiplimab to Sequential hyPOfractionated chemoRADiotherapy in unfit or elderly patients with unresectable stage III non-small cell lung cancer
Protocol code: IFCT-2401 SPORADIC
Sponsor: Intergroupe Francophone De Cancerologie Thoracique (Patient organisation/association). Phase: Therapeutic exploratory (Phase II). Countries: France (ongoing, recruiting).
Therapeutic area(s): Diseases [C] - Neoplasms [C04]
Gender: Female, Male. Age: 18-64 years, 65+ years. Enrolment: 152.
Status: Ongoing, recruiting. Start date (EU): 2025-11-07. Decision date: 2024-12-19. Results received: No. Last updated: 2026-05-13.

Condition(s): Unresectable stage III Non-Small Cell Lung Cancer
Product: PACLITAXEL, LIBTAYO 350 mg concentrate for solution for infusion., CARBOPLATIN

Primary endpoint: Progression-free survival (PFS)
Endpoint(s): Objective response (ORR) and disease control (DCR) rates according to RECIST 1.1 criteria., PFS rate at 12 months, 18 months and 3 years by treatment arm., OS curve and OS rate at 12 months, 18 months and 3 years by treatment arm., Neoadjuvant chemoimmunotherapy : Grade 3-4 toxicity rates by treatment arm according to CTCAE v5.0 up to 90 days after the end of immunotherapy, Percentage of discontinuation after two cycles of systemic therapy., Toxic death rate., Variation of respiratory function tests before neoadjuvant therapy and after neoadjuvant therapy (just before radiation) and after, at 3, 6 and 12 months., Global and specific quality of life questionnaire QLQ-C30 QLQ-LC29., Consolidation immunotherapy : Acute and late grade 3-4 toxicity rates by treatment arm according to CTCAE v5.0 up to 90 days after the end of immunotherapy.

Source: https://euclinicaltrials.eu/ctis-public/view/2024-517316-29-00